EU clinical trial 2023-510211-20-00: AntiCoagulation versus AcetylSalicylic Acid after Transcatheter Aortic Valve Implantation
Protocol code: ACASA-TAVI-2.5
Sponsor: Oslo University Hospital HF (Hospital/Clinic/Other health care facility). Phase: Therapeutic confirmatory (Phase III). Countries: Norway (ended).
Therapeutic area(s): Diseases [C] - Cardiovascular Diseases [C14]
Gender: Female, Male. Age: 65+ years. Enrolment: 360.
Status: Ended. Start date (EU): 2021-12-07. End date (EU): 2026-05-19. Decision date: 2024-10-23. Results received: No. Last updated: 2025-06-23.

Condition(s): Aortic stenosis
Product: RIVAROXABAN, APIXABAN, RIVAROXABAN, ACETYLSALICYLIC ACID, APIXABAN, EDOXABAN, EDOXABAN

Primary endpoint: Hypo-attenuated leaflet thickening, superiority, Safety Composite, non-inferiority (bleeding, thromboembolic events and all-cause mortality)
Endpoint(s): Clinical efficacy, superiority (Composite of of Freedom from all-cause mortality, Freedom from all stroke, Freedom from hospitalization for procedure- or valve-related causes, Freedom from KCCQ overall summary score <45 or decline from baseline of >10 points), Safety Composite, superiority (bleeding, thromboembolic events and all-cause mortality), Thromboembolic events, superiority (Composite of myocardial infarction or stroke of any cause), Bleeding events, superiority (Bleeding events according to VARC-3 definitions), All-cause mortality, superiority, Safety outcomes in safety population (adverse events, serious adverse events, individual bleeding outcomes), Long-term outcomes at 5 and 10 years (Major Adverse Cardiovascular Events/MACE: The rate of the composite of Cardiac death, Aortic valve re-intervention, Stroke, Myocardial infarction, Heart failure hospitalization and Major, life-threatening, or disabling bleeding)

Source: https://euclinicaltrials.eu/ctis-public/view/2023-510211-20-00